EU clinical trial 2025-524648-37-00: A Randomized, Open Label, 3-arm Phase 3 Study of Precemtabart Tocentecan with or Without Bevacizumab Compared to Trifluridine/Tipiracil plus Bevacizumab in Participants with Previously Treated Metastatic Colorectal Cancer (PROCEADE-CRC-03)
Protocol code: MS914001_0002
Sponsor: Merck Healthcare KGaA (Pharmaceutical company). Phase: Therapeutic confirmatory (Phase III). Countries: Belgium (authorised, recruitment pending), Germany (authorised, recruitment pending), France (authorised, recruitment pending), Denmark (authorised, recruitment pending), Poland (authorised, recruitment pending), Spain (authorised, recruitment pending), Netherlands (authorised, recruitment pending), Italy (authorised, recruitment pending), Austria (authorised, recruitment pending).
Therapeutic area(s): Diseases [C] - Neoplasms [C04]
Gender: Female, Male. Age: 18-64 years, 65+ years. Enrolment: 323.
Status: Authorised, recruitment pending. Decision date: 2026-07-14. Results received: No. Last updated: 2026-08-06.
Decision dates by country: AT: 2026-07-20, FR: 2026-07-20, IT: 2026-07-15, ES: 2026-08-04, PL: 2026-07-20, NL: 2026-08-04, DE: 2026-07-17, DK: 2026-07-14, BE: 2026-07-14

Condition(s): Metastatic colorectal cancer
Product: Lonsurf 15 mg/6.14 mg film-coated tablets, Lonsurf 15 mg/6.14 mg film-coated tablets, M9140, Lonsurf 15 mg/6.14 mg film-coated tablets, Avastin 25 mg/ml concentrate for solution for infusion., Avastin 25 mg/ml concentrate for solution for infusion., Lonsurf 20 mg/8.19 mg film-coated tablets, Lonsurf 20 mg/8.19 mg film-coated tablets, Lonsurf 20 mg/8.19 mg film-coated tablets

Primary endpoint: Arm 1, 2 and 3: overall survival (OS)
Endpoint(s): Arm 1 and Arm 2: overall survival (OS), Progression free survival (PFS), Objective response (OR) according to RECIST v1.1 as assessed by Investigator, Duration of response (DoR) according to RECIST v1.1 as assessed by Investigator, Number of Participants with Adverse Events (AEs) and Treatment Related Adverse Events, Observed Concentration at End of Infusion (CEOI), Concentration Observed at the end of a Dosing Interval Immediately Before next Dosing (Ctrough), Number of Participants with Anti-Drug Antibody as measured by ADA assay, Change from Baseline in Global Health Status, Physical, and Role Functioning Subscale Scores of European Organization for research and Treatment of Cancer Quality of Life Core Questionnaire (EORTC QLQ-C30)

Source: https://euclinicaltrials.eu/ctis-public/view/2025-524648-37-00